EU clinical trial 2024-510998-26-00: A first-in-human study to learn how safe the study treatment BAY2862789 is, to find the best dose, how it affects the body, what maximum amount can be given, how it moves into, through and out of the body, and how it acts on different tumors in participants with advanced solid tumors
Protocol code: 22231
Sponsor: Bayer AG (Pharmaceutical company). Phase: Human Pharmacology (Phase I)- First administration to humans. Countries: Spain (ended).
Therapeutic area(s): Diseases [C] - Neoplasms [C04]
Gender: Female, Male. Age: 18-64 years, 65+ years. Enrolment: 7.
Status: Ended. Start date (EU): 2024-09-18. End date (EU): 2025-09-22. End date: 2025-09-26. Decision date: 2024-08-20. Results received: No. Last updated: 2025-05-28.
Decision dates by country: ES: 2024-08-21

Condition(s): Advanced solid tumors, Non-small cell lung cancer

Source: https://euclinicaltrials.eu/ctis-public/view/2024-510998-26-00